EU clinical trial 2023-506394-35-02: Dose-finding and safety study of a new Shigella vaccine combined with an adjuvant in the Netherlands and Zambia
Protocol code: SUNSHINE
Sponsor: Academisch Ziekenhuis Leiden (Hospital/Clinic/Other health care facility). Phase: Human Pharmacology (Phase I)- Other. Countries: Netherlands (ended).
Therapeutic area(s): Diseases [C] - Digestive System Diseases [C06]; Diseases [C] - Bacterial Infections and Mycoses [C01]
Gender: Female, Male. Age: 18-64 years. Enrolment: 50.
Status: Ended. Start date (EU): 2024-09-12. End date (EU): 2025-09-26. End date: 2026-02-18. Decision date: 2024-07-02. Results received: No. Last updated: 2024-07-02.

Condition(s): Vaccination against shigellosis (in healthy adults)

Source: https://euclinicaltrials.eu/ctis-public/view/2023-506394-35-02